EU clinical trial 2024-514177-21-00: A Phase II, single-arm, open-label, long-term safety rollover trial of oral brigimadlin in patients with solid tumours
Protocol code: 1403-0032
Sponsor: Boehringer Ingelheim International GmbH, Boehringer Ingelheim Espana S.A. (Pharmaceutical company). Phase: Therapeutic exploratory (Phase II). Countries: Spain (ongoing, recruiting), Belgium (ongoing, recruitment ended), Hungary (ongoing, recruiting), Czechia (ongoing, recruiting), Denmark (ongoing, recruitment ended), France (ongoing, recruitment ended), Germany (ongoing, recruiting), Italy (ongoing, recruiting), Sweden (ongoing, recruitment ended), Norway (ended), Poland (ongoing, recruiting).
Therapeutic area(s): Diseases [C] - Neoplasms [C04]
Gender: Female, Male. Age: 18-64 years, 65+ years. Enrolment: 31.
Start date (EU): 2024-12-02. Decision date: 2024-10-23. Results received: No. Last updated: 2026-07-13.
Decision dates by country: NO: 2025-05-14, CZ: 2025-06-16, PL: 2025-06-30, BE: 2024-10-29, FR: 2025-06-18, DK: 2025-06-24, SE: 2025-06-13, DE: 2025-06-25, HU: 2024-11-06, IT: 2025-06-13, ES: 2024-10-23

Condition(s): Solid tumours
Product: BI 907828, BI 907828, BI 907828

Primary endpoint: Occurrence of treatment-emergent AEs according to CTCAE Version 5.0 during the entire treatment period

Source: https://euclinicaltrials.eu/ctis-public/view/2024-514177-21-00